EU clinical trial 2023-509781-37-00: Phase I/II Study of the Safety, Pharmacokinetics, and Preliminary Clinical Activity of BT8009 in Patients with Nectin-4 Expressing Advanced Malignancies.
Protocol code: BT8009-100
Sponsor: Bicycletx Limited (Pharmaceutical company). Phase: Phase I and Phase II (Integrated)- First administration to humans. Countries: Italy (ongoing, recruitment ended), France (ongoing, recruitment ended), Spain (ongoing, recruitment ended).
Therapeutic area(s): Diseases [C] - Neoplasms [C04]
Gender: Female, Male. Age: 18-64 years, 65+ years. Enrolment: 254.
Status: Ongoing, recruitment ended. Start date (EU): 2021-04-12. Decision date: 2024-05-28. Results received: No. Last updated: 2026-07-06.
Decision dates by country: ES: 2024-05-31, IT: 2024-06-03, FR: 2024-05-28

Condition(s): Nectin-4 Expressing Advanced Malignancies.
Product: Zelenectide Pevedotin, PEMBROLIZUMAB, BT8009

Primary endpoint: 1. Incidence of TEAEs, including lab, ECG, vital sign abnormalities (CTCAE v5.0) (A-1,A-2, B-8, B-9, &C)., 2. Incidence of dose-limiting tox (A-1,A-2)., 3. ORR per RECIST v1.1 criteria (B)., 4. Plasma concentrations of zelenectide pevedotin (BT8009) and MMAE with derivations including Cmax, Cmin, AUC, and elimination t(1/2) (D).
Endpoint(s): 1. ORR, DOR, clinical benefit rate (CR + PR + SD ≥ 16 weeks), PFS, all assessed per RECIST v1.1 criteria, and OS (A, C and D)., 2. Plasma concentrations of zelenectide pevedotin (BT8009) and MMAE with derivations including Cmax, Cmin, AUC, and elimination half-life t(1/2) (A, B, C and D)., 3. Measurement of ADA (A, C and D)., 4. TEAEs and laboratory, ECG and vital sign abnormalities using CTCAE v5.0 criteria (B, D)., 5. DOR, clinical benefit rate (CR + PR + SD ≥ 16 weeks), PFS, all assessed per RECIST v1.1 criteria, and OS (B)., 6. ORR by Nectin-4 status per RECIST v1.1 criteria (B)., 7. Plasma concentrations of zelenectide pevedotin (BT8009) and MMAE with derivations including Cmax, Cmin, AUC, and elimination half-life t(1/2) (B)., 8. Measurement of ADA (B).

Source: https://euclinicaltrials.eu/ctis-public/view/2023-509781-37-00